EU clinical trial 2024-511507-42-00: Study of posaconazole prophylaxis in patients receiving hematopoietic stem cell allograft (allo-HSC) at high risk of invasive fungal infection (IFI): POSALLO study
Sponsor: Centre Hospitalier Universitaire De Nantes (Hospital/Clinic/Other health care facility). Phase: Therapeutic exploratory (Phase II). Countries: France (ongoing, recruiting).
Therapeutic area(s): Diseases [C] - Hemic and Lymphatic Diseases [C15]
Gender: Female, Male. Age: 18-64 years, 65+ years. Enrolment: 30.
Status: Ongoing, recruiting. Start date (EU): 2024-11-08. Decision date: 2024-07-23. Results received: No. Last updated: 2024-07-23.

Condition(s): 30 adult patients due to receive an allograft for a myeloid or lymphoid hematological malignancy with an HLA-matched donor from the family or from the international donor file will be included in the hematology departments of the Nantes University Hospital.
Product: Noxafil 300 mg concentrate for solution for infusion, POSACONAZOLE

Primary endpoint: The primary endpoint is plasma residual posaconazole concentration ([C]min), measured on day 8 of posaconazole initiation. A [C]min > 0.7mg/l is considered effective
Endpoint(s): Monitoring of residual plasma concentrations [C]min up to Day 100, a)clinical record taken 2/week during hospitalization and then 1/week to describe clinical symptoms leading to malabsorption:nausea,vomiting,diarrhea,mucositis,colitis. Symptom intensity will be assessed (NCI CTCAE v5), b)Adherence to treatment monitored daily during hospitalization (paramedical staff). Once home, adherence assessed 1/week by the doctor in charge of the patient, c)All co-medications recorded throughout course of posaconazole treatment, based on data from patient's medical record, The physician in charge of the patient should specify the reason(s) for IV administration of the treatment, Description of situations leading to initial non-administration or early discontinuation of posaconazole, Description of posaconazole-related toxicities according to NCI CTCAE v5 classification, a)Engraftment assessed on hematological reconstitution (number of days of aplasia with PNN <0.5 G/L and platelets < 20, number of platelet and cell transfusions), b) OS : Survival between day 0 of transplantation and date of death or last follow-up, c) DFS : Survival between day 0 of transplant and date of relapse, death or last follow-up, d) NRM : Any death unrelated to relapse or disease progression, e) Any documented disease recurrence, f) Acute GVH grade 2-4 according to Mount Sinai criteria, g) Extensive chronic GVH according to NCI criteria, h) GRFS: Median relapse-free survival without grade 3-4 acute GVHD or chronic GVHD requiring systemic treatment, Post-transplant grade 3 and 4 adverse events (dates of occurrence) (NCI CTCAE version 5 criteria)

Source: https://euclinicaltrials.eu/ctis-public/view/2024-511507-42-00